EU clinical trial 2024-511867-27-00: Impact of Metformin on Peripheral Arterial Calcification in Type 1 Diabetes (IMPACT-1D)
Protocol code: D20180102
Sponsor: Assistance Publique Hopitaux De Paris (Hospital/Clinic/Other health care facility). Phase: Therapeutic confirmatory (Phase III). Countries: France (ongoing, recruiting).
Therapeutic area(s): Diseases [C] - Nutritional and Metabolic Diseases [C18]
Gender: Female, Male. Age: 18-64 years, 65+ years. Enrolment: 230.
Status: Ongoing, recruiting. Start date (EU): 2021-06-02. Decision date: 2024-09-10. Results received: No. Last updated: 2024-09-10.

Condition(s): Vascular calcification and type 1 diabetes
Product: METFORMINE ARROW LAB 1000 mg, comprimé pelliculé sécable, Placebo de metformine Arrow Lab 1000 mg - Composition: Cellulose microcristalline; Lactose monohydraté; Stéarate de magnésium (vegetable origin); Opadry TM 07F28588; Eau purifiée

Primary endpoint: Difference between below-knee arterial calcification score evaluated by CT-scan at T0 and T2years in type 1 diabetic patients treated or not with metformin.
Endpoint(s): Difference between below-knee arterial ultrasonographic occlusion score at T0 and T2years in type 1 diabetic patients supplemented or not with metformin., Difference between ankle and toe brachial indexes at T0 and T2years in type 1 diabetic patients supplemented or not with metformin., Difference between pulse wave velocity at T0 and T2 years in type 1 diabetic patients supplemented or not with metformin., Difference between coronary calcification score evaluated by CT-scan at T0 and T2years in type 1 diabetic patients treated or not with metformin., Difference between below-knee arterial calcification score progression between T0 and T2years in type 1 diabetic patients treated or not with metformin and with initial below-knee arterial calcification score ≤ and >400.

Source: https://euclinicaltrials.eu/ctis-public/view/2024-511867-27-00